EU clinical trial 2023-509121-51-00: B7451023 - A 16-Week, Multicenter, Interventional, Phase 3, Randomized, Double-Blind, Placebo-Controlled, Parallel Group Study to Investigate Efficacy and Safety of Abrocitinib in Children 6 to Less Than 12 Years of Age With Moderate-to-Severe Atopic Dermatitis
Protocol code: B7451023
Sponsor: Pfizer Inc. (Pharmaceutical company). Phase: Therapeutic confirmatory (Phase III). Countries: Hungary (ongoing, recruiting), Poland (ongoing, recruiting), Spain (ongoing, recruiting), Germany (ongoing, recruiting).
Therapeutic area(s): Diseases [C] - Skin and Connective Tissue Diseases [C17]
Gender: Female, Male. Age: 0-17 years. Enrolment: 54.
Status: Ongoing, recruiting. Start date (EU): 2025-09-30. Decision date: 2025-07-14. Results received: No. Last updated: 2026-07-27.
Decision dates by country: ES: 2025-07-23, HU: 2025-07-22, PL: 2025-07-28, DE: 2025-07-14

Condition(s): Moderate-to-Severe Atopic Dermatitis
Product: Abrocitinib Placebo, Abrocitinib

Primary endpoint: Response based on achieving validated Investigator’s Global Assessment (vIGA) score of clear (0) or almost clear (1) (on a 5- point scale) and a reduction from baseline of ≥2 points at Week 12, Response based on achieving ≥75% improvement from baseline in the Eczema Area and Severity Index (EASI) total score (EASI-75) at Week 12
Endpoint(s): Change from baseline (CFB) in the Worst Itch Numerical Rating Scale (WI-NRS) at Week 2, Response based on achieving at least a 4-point improvement from baseline in the WI-NRS at Week 12, Response based on achieving WI-NRS < 2 at Week 12, Response based on achieving vIGA score of clear (0) or almost clear (1) (on a 5-point scale) and a reduction from baseline of ≥2 points at all scheduled time points (except for the time point analyzed for the primary endpoints), Response based on achieving ≥50%, ≥75%, ≥90%, 100% improvement from baseline in the EASI total score (EASI-50, EASI-75, EASI-90, EASI-100) at all scheduled time points (except for the time point analyzed for the primary endpoints), Response based on achieving at least a 4-point improvement from baseline in the WI-NRS at all scheduled time points (except for the time point analyzed for the key secondary endpoint), Response based on achieving WI-NRS <2 at all scheduled time points (except for the time point analyzed for the key secondary endpoint), Response based on achieving WI-NRS <2 and EASI-90 at all scheduled time points, Time from baseline to achieving at least a 4- point improvement in the WI-NRS scale, Percent CFB in EASI total score at all scheduled time points, CFB in the Worst Itch Numerical Rating Scale (WI-NRS) at all scheduled time points (except for the time point analyzed for the key secondary endpoint), CFB in the percentage Body Surface Area (BSA) affected at all scheduled time points, CFB in Children’s Dermatology Life Quality Index (CDLQI) at all scheduled time points, CFB in Patient-Oriented Eczema Measure (POEM) at all scheduled time points, CFB in Dermatitis Family Impact (DFI) score at all scheduled time points, Topical corticosteroids- and topical calcineurin inhibitor-free days, CFB in the length of time scratching at night at all scheduled time points, CFB in the sleep efficiency at all scheduled time points, The incidence of treatment-emergent adverse events, serious adverse events and adverse events leading to discontinuation, The incidence of clinically significant laboratory abnormalities, Immune response to diphtheria, tetanus, and acellular pertussis vaccine (DTaP/Tdap) and/or pneumococcal vaccines in participants who received DTaP/Tdap and/or pneumococcal vaccination, Acceptability and Palatability Questionnaire to rate overall formulation taste and dosing experience.

Source: https://euclinicaltrials.eu/ctis-public/view/2023-509121-51-00